EU clinical trial 2024-517592-20-00: Intravenous MELAtonin for Preventing Agitation and Emergence Delirium in children. The MELA-PAED trial: a randomized, double-blind, placebo-controlled clinical trial.
Protocol code: 20211125
Sponsor: Rigshospitalet (Hospital/Clinic/Other health care facility). Phase: Therapeutic confirmatory (Phase III). Countries: Denmark (ongoing, recruitment ended).
Therapeutic area(s): Diseases [C] - Nervous System Diseases [C10]
Gender: Female, Male. Age: 0-17 years. Enrolment: 676.
Status: Ongoing, recruitment ended. Start date (EU): 2026-05-30. Decision date: 2024-11-11. Results received: No. Last updated: 2026-06-24.

Condition(s): Emergence delirium
Product: Melatonin, Natriumklorid Fresenius Kabi 9 mg/ml

Primary endpoint: Emergence agitation
Endpoint(s): Opioid consumption, Non-serious adverse events

Source: https://euclinicaltrials.eu/ctis-public/view/2024-517592-20-00